EU clinical trial 2022-500302-18-00: A Randomized Phase 2 Study of Adjunctive EQU-001 for Uncontrolled Focal Onset Seizures
Protocol code: EQU-202
Sponsor: Equilibre Biopharmaceuticals B.V. (Pharmaceutical company). Phase: Therapeutic exploratory (Phase II). Countries: Sweden (ended), Italy (ended), France (ended), Spain (ended), Netherlands (ended), Czechia (ended), Lithuania (ended), Poland (ended).
Therapeutic area(s): Diseases [C] - Nervous System Diseases [C10]
Gender: Female, Male. Age: 18-64 years, 65+ years. Enrolment: 123.
Status: Ended. End date (EU): 2023-07-07. Decision date: 2023-02-01. Results received: Yes. Last updated: 2023-06-21.
Decision dates by country: NL: 2023-03-06, ES: 2023-02-01, PL: 2023-05-29, SE: 2023-02-06, LT: 2023-03-13, IT: 2023-02-24, FR: 2023-02-07, CZ: 2023-02-15

Condition(s): Epilepsy
Product: EQU-001, Identical to IMP except for Active Substance

Primary endpoint: Median percentage change in the overall number of countable observable seizures per 28 day period relative to baseline in each treatment arm during the double-blind treatment period compared with placebo
Endpoint(s): 1. Median percentage change in the overall number of countable observable seizures per 28 day period relative to baseline in each treatment arm during the maintenance phase (treatment weeks 5 through 16) compared with placebo, 2. ≥ 50% responder rates in the treated arms as compared with placebo during double blind components of the study, which consist of the medication activation and maintenance period, 3. ≥ 50% responder rates in the treated arms as compared with placebo during the maintenance period alone (treatment weeks 5-16), 4. Difference in Patient Global Impression of Change Scale Score between each treated cohort and placebo at days 56 and 112, 5. Median percentage change in the number of countable observable seizures by subtype (focal aware with motor component, focal impaired aware, and focal to bilateral tonic-clonic) per 28 days during the maintenance period (treatment weeks 5-16) and during the entire double blind period in the treated and placebo arms, 6. Percent (%) of subjects who are seizure free by study days 29-112 (treatment weeks 5-16), 7. Percent of subjects who are seizure free in treated arms as compared with placebo during treatment weeks 5-16, 8. ≥ 70% and ≥ 90% response rates in treated arms compared with placebo during the maintenance period (treatment weeks 5-16), 9. Change from visit 2 (enrollment) in the Patient weighted Quality of Life in Epilepsy (QOLIE 31-P) scale score at days 56 and 112 in each treated arm as compared with placebo, 10. Number of subjects who withdraw from treatment because of an AE in each treatment arm, 11. Number of adverse events (CTCAE grade 2 or higher) in the treatment arms compared with placebo, 12. Change from visit 2 in Columbia-Suicide Severity Rating Scale responses in each treated arm as compared with placebo at each measured timepoint

Source: https://euclinicaltrials.eu/ctis-public/view/2022-500302-18-00